EU clinical trial 2024-517078-52-00: Prospective multicenter randomized controlled double-blind label study of the prophylaxis of recurrent pouchitis after fecal microbiota transplant in UC with ileo-anal anastomosis.
Protocol code: RC17_0021
Sponsor: Centre Hospitalier Universitaire De Nantes (Hospital/Clinic/Other health care facility). Phase: Therapeutic confirmatory (Phase III). Countries: France (ongoing, recruitment ended).
Therapeutic area(s): Diseases [C] - Digestive System Diseases [C06]
Gender: Female, Male. Age: 18-64 years, 65+ years. Enrolment: 42.
Status: Ongoing, recruitment ended. Start date (EU): 2026-01-19. Decision date: 2024-09-03. Results received: No. Last updated: 2025-03-06.

Condition(s): Patients operated with an IPAA for ulcerative colitis woth active recurrent pouchitis.
Product: Fresh donor faeces (faecal matter), 0.9% Sodium Chloride Intravenous Infusion Solution

Primary endpoint: Delay between the date of transplantation and the date of the Clinical and endoscopic relapse defined by a Pouchitis Disease Activity Index (Appendix) ≥ 7 points.
Endpoint(s): Relapse at week 24 defined as a Pouchitis Disease Activity Index (PDAI) superior or equal to 7 at week 24, Relapse at week 52 defined as a Pouchitis Disease Activity Index (PDAI) superior or equal to 7 at week 52, Delay within the transplantation and the instauration of an antibiotherapy or alternative treatment (immunosuppressive and/or biotherapy and/or corticotherapy), Registered of adverse events defined by Common Terminology Criteria for Adverse Events (4.3) during 104 weeks post-transplantation according to ANSM recommendation., Fecal microbiota engraftment at 8 weeks defined by : Sorensen’s index [receiver 8 weeks after FMT vs donor] > Sorensen’s index [receiver 8 weeks after FMT vs receiver before FMT]) with Sorensen’s index [receiver 8 weeks after FMT vs donor] = 0.6. To assess this endpoint, fecal microbiota composition will be analyzed for donor sample, receiver sample before FMT and 8 weeks after FMT, using 16S sequencing (Illumina Miseq technology), IBD Disability Index at weeks -2, baseline, 8, 24, 52 and unscheduled visit

Source: https://euclinicaltrials.eu/ctis-public/view/2024-517078-52-00